EU clinical trial 2023-504251-27-00: A Phase 1/2 Open-label, Multicenter Study to Assess the Safety, Tolerability, Pharmacokinetics, Pharmacodynamics, and Efficacy of PC14586 in Patients with Locally Advanced or Metastatic Solid Tumors Harboring a TP53 Y220C Mutation (PYNNACLE).
Protocol code: PMV-586-101
Sponsor: Pmv Pharmaceuticals Inc. (Pharmaceutical company). Phase: Phase I and Phase II (Integrated)- First administration to humans. Countries: Italy (ongoing, recruiting), Germany (ongoing, recruiting), France (ongoing, recruiting), Spain (ongoing, recruiting).
Therapeutic area(s): Diseases [C] - Neoplasms [C04]
Gender: Female, Male. Age: 18-64 years, 65+ years. Enrolment: 105.
Status: Ongoing, recruiting. Start date (EU): 2024-05-27. Decision date: 2024-04-24. Results received: No. Last updated: 2026-08-07.
Decision dates by country: FR: 2024-04-24, IT: 2024-05-09, DE: 2024-04-29, ES: 2024-04-24

Condition(s): Locally Advanced or Metastatic Solid Tumors Harboring a TP53 Y220C Mutation
Product: PC14586

Primary endpoint: 1. Overall Response Rate (ORR) per Blinded Independent Central Review (BICR) assessment (RECIST v1.1) across all cohorts., 2. ORR per BICR assessment (RECIST v1.1) in ovarian cancer cohort.
Endpoint(s): 1. ORR across all cohorts- RECIST v1.1 as assessed by Investigator, 2. ORR in ovarian cancer cohort - RECIST v1.1 as assessed by Investigator, 3. Incidence of AEs and SAEs, and changes between baseline and post-baseline laboratory assessments, ECGs, ECOG performance status, vital signs, and physical exams. Toxicities will be graded using CTCAE v5.0 (NCI, 2017), 4. TTR, DoR, DCR at 6, 12, 18, and 24 weeks, PFS across all cohorts and in ovarian cancer only - RECIST v1.1 as assessed by BICR - RECIST v1.1 as assessed by Investigator, 5. OS across all cohorts and in ovarian cancer only, 6. Rezatapopt concentrations (and concentrations of metabolites), 7. Plasma PK parameters: Cmax, Tmax, AUC0-t, AUCtau, Ctrough/Ctau, 8. EORTC QLQ-C30

Source: https://euclinicaltrials.eu/ctis-public/view/2023-504251-27-00